EU clinical trial 2025-524435-39-00: A randomized, double-blind, placebo-controlled study to evaluate the efficacy and safety of 250 mg lebrikizumab in patients with localized scleroderma (LEMO)
Sponsor: Charite Universitaetsmedizin Berlin KöR (Hospital/Clinic/Other health care facility). Phase: Therapeutic exploratory (Phase II). Countries: Germany (authorised, recruitment pending).
Therapeutic area(s): Diseases [C] - Skin and Connective Tissue Diseases [C17]
Gender: Female, Male. Age: 18-64 years, 65+ years. Enrolment: 78.
Status: Authorised, recruitment pending. Decision date: 2026-05-08. Results received: No. Last updated: 2026-07-03.

Condition(s): Localized Scleroderma
Product: Matching placebo to IMP, Ebglyss 250 mg solution for injection in pre-filled syringe

Primary endpoint: mLoSSI score after 24 weeks. Absolute change from baseline visit in mLoSSI score will be compared between groups

Source: https://euclinicaltrials.eu/ctis-public/view/2025-524435-39-00